EU clinical trial 2023-503224-66-00: A Phase 3, multicenter, randomized, double-blind, placebo-controlled, parallel-group study to evaLuate the effIcacy and safety of abeLacimab in high-risk patients with Atrial fibrillation who have been deemed unsuitable for oral antiCoagulation (LILAC)
Protocol code: CMAA868A2302(ANT-010
Sponsor: Anthos Therapeutics Inc. (Pharmaceutical company). Phase: Therapeutic confirmatory (Phase III). Countries: Germany (ongoing, recruiting), Czechia (ongoing, recruiting), Romania (ongoing, recruiting), Bulgaria (ongoing, recruiting), Hungary (ongoing, recruiting), Poland (ongoing, recruiting), Spain (ongoing, recruiting), Italy (ongoing, recruiting), Latvia (ongoing, recruiting), Estonia (ongoing, recruiting), Croatia (ongoing, recruiting), Slovakia (ongoing, recruiting), Sweden (ongoing, recruiting), Finland (ongoing, recruiting), Greece (ongoing, recruiting).
Therapeutic area(s): Diseases [C] - Cardiovascular Diseases [C14]
Gender: Female, Male. Age: 65+ years. Enrolment: 1729.
Status: Ongoing, recruiting. Start date (EU): 2023-10-31. Decision date: 2023-06-12. Results received: No. Last updated: 2026-04-22.
Decision dates by country: IT: 2023-06-19, GR: 2025-04-29, ES: 2023-06-12, CZ: 2023-06-16, LV: 2024-02-08, PL: 2023-06-19, SK: 2025-04-03, RO: 2023-06-19, SE: 2025-04-03, BG: 2023-06-19, HR: 2025-04-14, DE: 2023-06-14, FI: 2025-04-28, HU: 2023-06-16, EE: 2024-04-02

Condition(s): Atrial Fibrillation
Product: Placebo 0 mg/1mL solution for infusion/injection, matching abelacimab, Abelacimab 150 mg/ml solution for infusion

Primary endpoint: The primary efficacy endpoint is the time to first occurrence of confirmed ischemic stroke or SE., The primary safety endpoint is the time to first occurrence of adjudicated BARC type 3c/5 bleeding.
Endpoint(s): The secondary efficacy endpoints include: • Composite of ischemic stroke, SE, MI, VTE, or acute limb ischemia • Composite of ischemic stroke, SE, or BARC type 3c/5 bleeding • Cardiovascular (CV) mortality • All-cause mortality • Composite of ischemic stroke, SE, MI, VTE, acute limb ischemia, or ISTH major bleeding"

Source: https://euclinicaltrials.eu/ctis-public/view/2023-503224-66-00